EU clinical trial 2024-518531-10-00: A Phase II study of L19IL2/L19TNF in patients with skin cancers amenable to intralesional treatment.
Sponsor: Philogen S.p.A. (Pharmaceutical company). Phase: Therapeutic exploratory (Phase II). Countries: Spain (ongoing, recruitment ended), France (ongoing, recruitment ended), Italy (ongoing, recruitment ended).
Therapeutic area(s): Diseases [C] - Neoplasms [C04]
Gender: Female, Male. Age: 18-64 years, 65+ years. Enrolment: 26.
Status: Ongoing, recruitment ended. Start date (EU): 2024-11-26. Decision date: 2024-11-18. Results received: No. Last updated: 2026-03-16.
Decision dates by country: FR: 2024-11-18, ES: 2024-11-18, IT: 2024-11-25

Condition(s): Phase II, open label, multicentric, proof-of-principle basket trial in patients with malignant tumors of the skin amenable to intratumoral injection, and in a curative or neoadjuvant or palliative intention, including: • Basal cell carcinoma (BCC); • Cutaneous squamous cell carcinoma (cSCC); • Merkel cell carcinoma (MCC); • Keratoacanthoma (KA); • Malignant adnexal tumors of the skin (MATS); • Tumors from cutaneous T-cell lymphoma (CTCL); • Kaposi’s sarcoma (KS)
Product: Fibromun, Darleukin

Primary endpoint: • Efficacy of L19IL2/L19TNF measured as: o Confirmed best overall response rate (BORR) [Complete Response (CR) + Partial Response (PR)] for each tumor type measured according to RECIST v1.1 criteria. Confirmation of CR requires histopathological analysis of exeresis specimens for lesions removed by surgery or of biopsies in all other cases.
Endpoint(s): Efficacy of L19IL2/L19TNF measured as: Disease control rate (DCR) [Complete Response (CR) + Partial Response (PR) + Stable Disease (SD)] for each tumor type measured according to RECIST v1.1 criteria., Efficacy of L19IL2/L19TNF measured as: Local progression free survival (LPFS) on the treated tumors only., Efficacy of L19IL2/L19TNF measured as: Progression-free survival (PFS), assessed separately in patients who are not resected after curative intention and in patients who undergo secondary surgery (neoadjuvant intention), whatever the RECIST response to treatment, taking into account appearance of new lesions and occurrence of metastases, etc., Efficacy of L19IL2/L19TNF measured as: Among tumors not initially amenable to surgery, a proportion which are finally resected or disappear., Efficacy of L19IL2/L19TNF measured as: Effect on non-treated lesions, if any., Efficacy of L19IL2/L19TNF measured as: Pathological response for each tumor type in surgical specimens from tumors which are resected after treatment, or in biopsy for the other types., Safety of intratumoral administration of L19IL2/L19TNF.

Source: https://euclinicaltrials.eu/ctis-public/view/2024-518531-10-00